EU clinical trial 2024-515278-28-00: A Prospective, Open-label Pilot Study to Evaluate Effector Mechanisms of Hyperbaric Oxygen Therapy in Patients with Moderate-to-Severe Ulcerative Colitis: The PARADOX study
Sponsor: Stichting Amsterdam UMC (Hospital/Clinic/Other health care facility). Phase: Therapeutic use (Phase IV). Countries: Netherlands (ended).
Therapeutic area(s): Diseases [C] - Immune System Diseases [C20]; Analytical, Diagnostic and Therapeutic Techniques and Equipment [E] - Therapeutics [E02]; Phenomena and Processes [G] - Immune system processes [G12]; Diseases [C] - Digestive System Diseases [C06]
Gender: Female, Male. Age: 18-64 years, 65+ years. Enrolment: 24.
Status: Ended. Start date (EU): 2024-11-15. End date (EU): 2026-01-06. Decision date: 2024-11-15. Results received: No. Last updated: 2024-11-15.

Condition(s): ulcerative colitis
Product: OXYGENE MEDICINAL AIR LIQUIDE REUNION 200 bar, gaz pour inhalation, en bouteille

Primary endpoint: Co-primary endpoints include: methylome of peripheral blood and mucosal monocytes, mucosal single transcriptomics, cytokine profiles, microbiome, drug concentrations and blood flow
Endpoint(s): - Response after completion of HBOT and at week 12 post-treatment defined as a reduction in complete MAYO score of 3 points AND at least 1 point reduction in the MAYO ES WITHOUT escalating therapy such as dose escalations, switching to another drug, adding corticosteroids or colectomy, - Clinical disease activity assessed by the PRO-2 score during treatment at day 2, 4, 6 and the last day of treatment, for the group with 20 and 30 sessions: day 10 and 14 and the group with 30 sessions: day 20,

Source: https://euclinicaltrials.eu/ctis-public/view/2024-515278-28-00